EU clinical trial 2024-515492-34-00: C4161001: PHASE 1/2A DOSE ESCALATION, FINDING AND EXPANSION STUDY EVALUATING SAFETY, TOLERABILITY, PHARMACOKINETICS, PHARMACODYNAMICS AND ANTI TUMOR ACTIVITY OF PF-07104091 AS A SINGLE AGENT AND IN COMBINATION THERAPY
Protocol code: C4161001
Sponsor: Pfizer Inc. (Pharmaceutical company). Phase: Phase I and Phase II (Integrated)- Other. Countries: Bulgaria (ongoing, recruitment ended).
Therapeutic area(s): Diseases [C] - Neoplasms [C04]
Gender: Female, Male. Age: 18-64 years, 65+ years. Enrolment: 12.
Status: Ongoing, recruitment ended. Start date (EU): 2023-03-30. Decision date: 2024-11-27. Results received: No. Last updated: 2026-05-09.

Condition(s): Breast Cancer, Ovarian Cancer, SCLC (Part 1 also had TNBC and NSCLC)
Product: Fulvestrant EVER Pharma 250 mg Injektionslösung in einer Fertigspritze, LETROZOLE ACCORD HEALTHCARE 2,5 mg, comprimé pelliculé, IBRANCE 100 mg hard capsules, IBRANCE 125 mg hard capsules, IBRANCE 75 mg hard capsules

Primary endpoint: Part 1A, Part 1B and Part 1C: •First cycle DLTs. •AEs as characterized by type, frequency, severity, timing, seriousness, and relationship to study therapy. •Laboratory abnormalities as characterized by type, frequency, severity (as graded by NCI CTCAE version 5.0), and timing. •Vital sign abnormalities. •Heart rate corrected QT interval (eg, QTcF)., Part 2 •Preliminary antitumor activity measure for efficacy includes ORR, as assessed using RECIST 1.1. •Safety and tolerability: •Adverse Events as characterized by type, frequency, severity (as graded by NCI CTCAE v 5.0), timing, seriousness, and relationship to study therapy.•“Please refer protocol section 3 for more details.”
Endpoint(s): PK parameters of PF-07104091: •Single Dose Cmax, Tmax, AUClast, and as data permit, AUCinf, CL/F, Vz/F, and t1/2. •Multiple Dose (assuming steady state is achieved) Cmax,ss, Tmax,ss, AUCτ,ss, Cmin,ss, CL/F,ss, and as data permit, V/F, ss, t1/2, and Rac (AUCτ,ss/AUCτ,sd)., ORR, as assessed using RECIST version 1.1., Time to event endpoints: eg, DoR, PFS, TTP, CBR., Time to event endpoints: eg, DoR, PFS, CBR, overall survival OS and TTP., •PK parameters of PF-07104091. •Single dose: Cmax, Tmax and AUClast. •Multiple dose (assuming steady state is achieved): Cmax,ss, Tmax,ss, AUClast, Cmin,ss, and Rac., PK parameters of PF-07104091 given with and without food., Changes in cell cycle biomarkers (eg, phosphor Rb, Ki 67) in paired pre- and on treatment tumor biopsies.

Source: https://euclinicaltrials.eu/ctis-public/view/2024-515492-34-00